EU clinical trial 2025-523562-24-00: A First in Human Study to Assess Safety, Tolerability and Pharmacokinetics of a single dose of REGN22044 in Healthy Adults
Protocol code: R22044-HV-2533
Sponsor: Regeneron Pharmaceuticals Inc. (Pharmaceutical company). Phase: Human Pharmacology (Phase I)- First administration to humans. Countries: Belgium (authorised, recruitment pending).
Therapeutic area(s): Not possible to specify
Gender: Female, Male. Age: 18-64 years, 65+ years. Enrolment: 64.
Status: Authorised, recruitment pending. Decision date: 2026-05-11. Results received: No. Last updated: 2026-06-02.
Decision dates by country: BE: 2026-06-02

Condition(s): Heathy volunteer trial

Source: https://euclinicaltrials.eu/ctis-public/view/2025-523562-24-00